EU clinical trial 2023-503452-27-00: A randomized, open-label, multi-center phase III trial comparing tisagenlecleucel to standard of care in adult participants with relapsed or refractory follicular lymphoma
Protocol code: CCTL019E2301
Sponsor: Novartis Pharma AG (Pharmaceutical company). Phase: Therapeutic confirmatory (Phase III). Countries: Slovakia (ongoing, recruitment ended), Poland (ongoing, recruitment ended), Spain (ongoing, recruitment ended), Hungary (ongoing, recruitment ended), Romania (ended), Czechia (ongoing, recruitment ended), Austria (ongoing, recruitment ended).
Therapeutic area(s): Diseases [C] - Neoplasms [C04]
Gender: Female, Male. Age: 18-64 years, 65+ years. Enrolment: 58.
Start date (EU): 2024-01-02. Decision date: 2023-08-22. Results received: No. Last updated: 2026-08-04.
Decision dates by country: RO: 2023-08-28, AT: 2024-12-09, ES: 2023-08-24, PL: 2023-08-28, CZ: 2024-01-09, SK: 2023-08-22, HU: 2023-08-28

Condition(s): Adult patients with follicular B-cell non-Hodgkin lymphoma grade 1-3A, relapsed or refractory after at least two prior lines of systemic therapy
Product: CYCLOPHOSPHAMIDE MONOHYDRATE, VINCRISTINE SULFATE, PREDNISOLONE, FLUDARABINE PHOSPHATE, CYCLOPHOSPHAMIDE MONOHYDRATE, RITUXIMAB, PREDNISONE, LENALIDOMIDE, TOCILIZUMAB, BENDAMUSTINE HYDROCHLORIDE, DOXORUBICIN HYDROCHLORIDE, TISAGENLECLEUCEL

Primary endpoint: ●Progression free survival (PFS) based on Lugano response criteria, defined as time from randomization to the first of the following events to occur: ● progressive disease (by BIRC) ● death from any cause
Endpoint(s): ● Best overall response (BOR) as assessed by BIRC per Lugano response criteria. BOR is the best disease response observed from randomization until start of new anticancer therapy. ● CRR: The proportion of participants with BOR of complete response (CR), ● ORR: The proportion of participants with BOR of either CR or partial response (PR) ● OS: Time from randomization to date of death due to any cause ● TTNT: Time from randomization until start of new anticancer therapy or death due to any cause., ● Time from the date of first documented BIRC response of CR or PR to the date of first documented progression by BIRC or any cause of death, ● Summary of pre-existing and treatment induced immunogenicity (humoral) of tisagenlecleucel ● Levels of pre-exis ting and treatment induced immunogenicity. Cellular kinetic parameters, concentration,-time profile, and efficacy by humoral immunogenicity., ● Type, frequency and severity of serious and non-serious adverse events (AEs) and laboratory abnormalities and discontinuations due to adverse events, ● Summary of qPCR detected Chimeric Antigen Receptor (CAR) transgene levels in peripheral blood and bone marrow (and other tissues, if available) by timepoints and cellular kinetic parameters from peripheral blood transgene levels by clinical response status, RCL by VSV-g qPCR

Source: https://euclinicaltrials.eu/ctis-public/view/2023-503452-27-00